EU clinical trial 2024-517583-36-01: A PHASE II OPEN-LABEL STUDY OF UM171-EXPANDED CORD BLOOD TRANSPLANTATION IN PATIENTS WITH HIGH AND VERY HIGH-RISK ACUTE LEUKEMIA/MYELODYSPLASIA.
Protocol code: ECT-001-CB.004
Sponsor: Excellthera Inc. (Pharmaceutical company). Phase: Therapeutic exploratory (Phase II). Countries: Netherlands (authorised, recruitment pending).
Therapeutic area(s): Diseases [C] - Hemic and Lymphatic Diseases [C15]
Gender: Female, Male. Age: 18-64 years. Enrolment: 5.
Status: Authorised, recruitment pending. Decision date: 2024-11-29. Results received: No. Last updated: 2024-11-29.

Condition(s): High risk and very high risk acute leukemia/myelodysplasia requiring an allogeneic haematopoietic stem cell transplantation

Primary endpoint: Evaluate relapse-free survival at 1- and 2-years post-transplant
Endpoint(s): Kinetics of hematopoietic engraftment (Neutrophil engraftment and Platelet engraftment), Transplant related mortality (TRM), Incidence of acute and chronic GVHD, Incidence of grade 3 or higher infectious complications, Incidence of pre-engraftment and engraftment syndrome requiring therapy

Source: https://euclinicaltrials.eu/ctis-public/view/2024-517583-36-01